EU clinical trial 2023-508217-17-00: A Phase 3b Multicenter Open-label Trial of the Safety, Tolerability, and Efficacy of Tolvaptan in Infants and Children 28 days to less than 12 weeks of Age with Autosomal Recessive Polycystic Kidney Disease (ARPKD).
Protocol code: 156-12-204
Sponsor: Otsuka Pharmaceutical Development & Commercialization Inc. (Pharmaceutical company). Phase: Therapeutic confirmatory (Phase III). Countries: Belgium (ended), Spain (ended), Germany (ended), Poland (ended).
Therapeutic area(s): Diseases [C] - Congenital, Hereditary, and Neonatal Diseases and Abnormalities [C16]
Gender: Female, Male. Age: 0-17 years. Enrolment: 4.
Status: Ended. End date (EU): 2025-09-01. End date: 2025-12-10. Decision date: 2024-04-29. Results received: Yes. Last updated: 2024-12-02.
Decision dates by country: ES: 2024-04-29, DE: 2024-05-08, PL: 2024-05-27, BE: 2024-05-08

Condition(s): Autosomal Recessive Polycystic Kidney Disease
Product: Tolvaptan

Primary endpoint: Primary Efficacy: Percentage of subjects having RRT by 1 year of age
Endpoint(s): Main secondary efficacy endpoint: Rate of change of eGFR (eGFR Schwartz formula = 0.413 × height [or length, cm] /serum creatinine mg/dL) from pretreatment to post‑treatment after 2 years of treatment., Age-appropriate assessment of palatability and acceptability of suspension formulation., Change in sNa+ from baseline at each visit., Percentage of change in kidney size of height adjusted TKV at every time point from baseline to 24 months of treatment via ultrasound using ellipsoid methodology., Change from baseline (last assessment prior to dosing) in growth percentile trajectories for height (stature), weight, and head circumference at 3 months, 6 months, 12 months, 18 months, and 24 months., Summary of vital signs data., Adverse events (AEs), including rate of aquaretic AEs., Changes from baseline in serum creatinine and laboratory values including liver function tests (total bilirubin, ALT, AST, ALP, GGT).

Source: https://euclinicaltrials.eu/ctis-public/view/2023-508217-17-00